EU clinical trial 2024-518124-77-00: A clinical research study investigating how the body processes the new compound petrelintide in people with kidney problems
Protocol code: ZP8396-24059
Sponsor: Zealand Pharma A/S (Pharmaceutical company). Phase: Human Pharmacology (Phase I)- Other. Countries: Germany (ended).
Therapeutic area(s): Diseases [C] - Nutritional and Metabolic Diseases [C18]
Gender: Female, Male. Age: 18-64 years, 65+ years. Enrolment: 48.
Status: Ended. Start date (EU): 2025-03-26. End date (EU): 2025-11-25. Decision date: 2025-03-14. Results received: No. Last updated: 2025-11-21.

Condition(s): Weight management

Source: https://euclinicaltrials.eu/ctis-public/view/2024-518124-77-00